EU clinical trial 2023-506996-89-00: A Multicenter, Open-Label, Extension Study Evaluating the Safety and Efficacy of Bomedemstat for the Treatment of Participants Enrolled in a Prior Bomedemstat Clinical Study
Protocol code: MK-3543-017
Sponsor: Merck Sharp & Dohme LLC (Pharmaceutical company). Phase: Therapeutic confirmatory (Phase III). Countries: Italy (ongoing, recruiting).
Therapeutic area(s): Diseases [C] - Neoplasms [C04]
Gender: Female, Male. Age: 18-64 years, 65+ years. Enrolment: 25.
Status: Ongoing, recruiting. Start date (EU): 2024-06-13. Decision date: 2024-04-15. Results received: No. Last updated: 2026-06-08.

Condition(s): Myeloproliferative Neoplasms (Essential Thrombocythemia, Polycythemia Vera and Myelofibrosis)
Product: MK-3543, MK-3543, MK-3543, MK-3543

Primary endpoint: Percentage of participants with one or more adverse events (AEs), Percentage of participants who discontinued study treatment due to an AE
Endpoint(s): For participants with ET or PV: Duration of clinicohematologic response, For participants with ET or PV: Duration of hematologic remission, For participants with ET or PV: Transformation to MF or myelodysplastic syndrome (MDS)/ acute myeloid leukemia (AML), For participants with MF: Worsening of splenomegaly or transformation to MDS/AML, For participants with MF, ET, or PV: Thrombotic events, For participants with MF, ET, or PV: Major hemorrhagic events

Source: https://euclinicaltrials.eu/ctis-public/view/2023-506996-89-00